EU clinical trial 2023-503920-14-00: A Phase I-III, Multicenter Study Evaluating the Efficacy and Safety of Multiple Therapies in Cohorts of Patients Selected According to Biomarker Status, with Locally Advanced, Unresectable, Stage III Non-Small Cell Lung Cancer
Protocol code: BO42777
Sponsor: F. Hoffmann-La Roche AG (Pharmaceutical company). Phase: Therapeutic confirmatory (Phase III). Countries: Spain (ended), Norway (ended), Sweden (ongoing, recruitment ended), Poland (ended), France (ongoing, recruitment ended), Germany (ended), Netherlands (ended), Italy (ongoing, recruitment ended), Belgium (ongoing, recruitment ended).
Therapeutic area(s): Diseases [C] - Neoplasms [C04]
Gender: Female, Male. Age: 18-64 years, 65+ years. Enrolment: 39.
Start date (EU): 2024-01-02. Decision date: 2024-02-13. Results received: No. Last updated: 2026-08-04.
Decision dates by country: ES: 2024-02-19, NO: 2024-02-20, DE: 2024-03-14, PL: 2024-03-08, NL: 2024-02-13, SE: 2024-02-13, IT: 2024-03-11, FR: 2024-02-21, BE: 2024-02-23

Condition(s): Non-Small Cell Lung Cancer (NSCLC)
Product: IMFINZI 50 mg/mL concentrate for solution for infusion., Alecensa 150 mg hard capsules

Primary endpoint: 1. Progression-free survival (PFS), as determined by Blinded independent central review (BICR) per RECIST v1.1
Endpoint(s): 1. PFS, defined as the time from randomization to the first documented disease progression, as determined by the investigator per RECIST v1.1, or death from any cause, whichever occurs first, 2. Time to central nervous system (CNS) progression, as determined by BICR and investigator per RECIST v1.1, 3. Distant metastasis-free survival (DMFS), as determined by BICR and investigator per RECIST v1.1, 4. Objective response rate (ORR), as determined by BICR and investigator per RECIST v1.1, 5. Duration of response (DOR), as determined by BICR and investigator per RECIST v1.1, 6. Overall survival (OS), 7. Time-to-confirmed deterioration (TTCD), in the following patient-reported scales and lung cancer symptoms: Physical functioning, Role functioning, Cough, Chest pain, Dyspnea, 8. Change from baseline score as measured through the use of the European Organisation for the Research and Treatment of Cancer Quality of Life Questionnaire Core 30 (EORTC QLQ-C30) at 5, 11, and 17 months in the following patient-reported scales and lung cancer symptoms: Physical functioning, Role functioning, Cough, Chest pain, Dyspnea, 9. Incidence, type, and severity of adverse events according to National Cancer Institute Common Terminology Criteria for Adverse Events, Version 5.0 (NCI CTCAE v5.0), 10. Changes in vital signs, physical findings, and clinical laboratory results during and following administration of protocol-specified investigational medicinal products (IMPs)

Source: https://euclinicaltrials.eu/ctis-public/view/2023-503920-14-00